EU clinical trial 2023-506004-93-00: A Phase 2, Dose-finding, Randomized, Double-blind, Placebo-controlled, Multicenter Study to Evaluate the Safety and Efficacy of Efavaleukin Alfa Induction Therapy in Subjects with Moderately to Severely Active Ulcerative Colitis
Protocol code: 20170104
Sponsor: Amgen Inc. (Pharmaceutical company). Phase: Therapeutic exploratory (Phase II). Countries: Slovakia (ended), Latvia (ended), Finland (ended), France (ended), Czechia (ended), Spain (ended), Italy (ended), Germany (ended), Romania (ended), Bulgaria (ended), Belgium (ended), Denmark (ended), Poland (ended), Austria (ended), Hungary (ended), Netherlands (ended), Greece (ended).
Therapeutic area(s): Diseases [C] - Digestive System Diseases [C06]
Gender: Female, Male. Age: 18-64 years, 65+ years. Enrolment: 167.
Status: Ended. Start date (EU): 2022-03-01. End date (EU): 2024-08-27. Decision date: 2024-05-31. Results received: Yes. Last updated: 2024-07-30.
Decision dates by country: AT: 2024-05-31, BE: 2024-06-05, BG: 2024-06-10, CZ: 2024-06-04, DK: 2024-06-06, FI: 2024-06-04, FR: 2024-06-04, DE: 2024-06-05, GR: 2024-07-30, HU: 2024-06-03, IT: 2024-06-05, LV: 2024-06-03, RO: 2024-06-04, ES: 2024-06-03, NL: 2024-06-03, PL: 2024-06-03, SK: 2024-06-03

Condition(s): Ulcerative Colitis (UC)

Primary endpoint: Clinical remission at week 12
Endpoint(s): Clinical response at week 12, Endoscopic remission at week 12, Symptomatic remission at week 12, Combined endoscopic remission and histologic remission of the colon tissue at week 12, Change from baseline in histological score at week 12 as measured by Geboes score, Treatment-emergent adverse events

Source: https://euclinicaltrials.eu/ctis-public/view/2023-506004-93-00